EU clinical trial 2025-522533-54-00: Phase 2, Multicenter, Open label, Platform Study investigating ASP3082 in patients with Metastatic/Locally Advanced Non-Small-Cell Lung Cancer (NSCLC) and Pancreatic Ductal Adenocarcinoma (PDAC), with biomarker analysis to characterize response/resistance (UNLOCK ASP3082)
Protocol code: CSET 2025/4116
Sponsor: Institut Gustave Roussy (Hospital/Clinic/Other health care facility). Phase: Therapeutic exploratory (Phase II). Countries: France (ongoing, recruiting).
Therapeutic area(s): Diseases [C] - Neoplasms [C04]
Gender: Female, Male. Age: 18-64 years, 65+ years. Enrolment: 60.
Status: Ongoing, recruiting. Start date (EU): 2026-03-17. Decision date: 2026-01-28. Results received: No. Last updated: 2026-03-19.

Condition(s): Metastatic Non-small cell lung cancer (NSCLC) and Pancreatic ductal adenocarcinoma
Product: ASP3082, DEXTROSE INJECTION / BRADEX 5%

Primary endpoint: Best overall response (BOR) based on investigator assessment per RECIST v.1.1
Endpoint(s): Duration of response (DOR) • Clinical benefit rate (CBR) • Progression-free survival (PFS) • Overall survival (OS), Frequency and severity of all adverse events (AEs), treatment-emergent adverse events (TEAEs), and serious adverse events (SAEs), defined by the National Cancer Institute Common Terminology Criteria for Adverse Events version 5.0 (NCI-CTCAE v5.0) • Treatment discontinuation, interruptions, and dose reductions due to any AEs Frequency and severity of laboratory abnormalities defined by NCI-CTCAE v5.0, To evaluate pharmacodynamic changes, proteomic, genomic and other biomarkers that may correlate with treatment outcome • To characterize mechanisms of acquired resistance correlating with treatment outcome

Source: https://euclinicaltrials.eu/ctis-public/view/2025-522533-54-00